EU clinical trial 2025-525041-43-00: A Study to Learn How the Study Medicine Called Ibuzatrelvir is Taken up into the Blood of Healthy Adults After Taking Different Tablets of the Study Medicine Called Ibuzatrelvir.
Protocol code: C5091029
Sponsor: Pfizer Inc. (Pharmaceutical company). Phase: Human Pharmacology (Phase I)- Other. Countries: Belgium (ended).
Therapeutic area(s): Diseases [C] - Virus Diseases [C02]
Gender: Female, Male. Age: 18-64 years, 65+ years. Enrolment: 18.
Status: Ended. Start date (EU): 2026-04-07. End date (EU): 2026-06-29. End date: 2026-06-30. Decision date: 2026-04-01. Results received: No. Last updated: 2026-04-21.

Condition(s): Coronavirus disease 2019

Source: https://euclinicaltrials.eu/ctis-public/view/2025-525041-43-00